EU clinical trial 2023-507307-64-00: Non-inferiority, Phase IV, Open-label, Randomized Controlled Trial of primary Photodynamic Trans-urethral Resection of Bladder Tumors (PDD-TURBT) versus conventional white-light TURBT plus Repeated-TURBT (Re-TURBT) in Non-Muscle Invasive Bladder Cancers (NMIBCs) candidate for second look and resection
Sponsor: Universita' Degli Studi Di Roma La Sapienza (Educational Institution). Phase: Therapeutic use (Phase IV). Countries: Italy (ongoing, recruiting).
Therapeutic area(s): Diseases [C] - Neoplasms [C04]; Health Care [N] - Health Care Economics and Organizations [N03]
Gender: Female, Male. Age: 18-64 years, 65+ years. Enrolment: 258.
Status: Ongoing, recruiting. Start date (EU): 2025-12-22. Decision date: 2024-02-20. Results received: No. Last updated: 2024-02-20.

Condition(s): Non-muscle invasive bladder cancer (NMIBC)
Product: Hexvix 85 mg polvere e solvente per soluzione endovescicale

Primary endpoint: The relative proportions of patients with early BCa recurrence detected during first follow-up cystoscopy will be compared between the experimental and the standard of care arms. Given the different timetable pathway of the two arms under investigation, early BCa recurrence is defined in the experimental arm as any BCa recurrence at 3-months from primary PDD-TURBT while at 3-months from WL Re-TURBT in the standard of care arm.
Endpoint(s): The relative proportions of patient with late BCa recurrences (i.e., detected after 4.5 months follow-up) between the experimental and the standard of care arms., Time to late BCa recurrences (i.e., late disease-free interval), defined as first recurrence (including progression to muscle-invasive disease, distant metastases, and death due to bladder cancer) in patients without an early recurrence who had follow-up after 4.5 months (landmark analysis). Patients still alive without recurrence will be censored at the last follow-up. The time will be censored at death and/or radical cystectomy in the absence of recurrence (competing risk)., The relative proportions of patient with progression to MIBC over follow-up between the experimental and the standard of care arms., Time to progression to MIBC (i.e., progression-free interval) defined as the time from randomization to first increase to BCa stage T2 or higher or distant metastases. Patients still alive without progression will be censored at the last follow-up. The time will be censored upon death and/or radical cystectomy before progression (competing risks)., Standardized mean difference of total in-hospital cost and informal costs between the experimental and the standard of care arms. We will model costs and health state changes over a patient lifetime to estimate the incremental cost per Re-TURBT avoided, QALYs and costs to the NHS. This will be based on the updated version of the existing National Institute of Health Research (NIHR) HTA economic model using 2-year data from within the trial., Health related quality of life (HRQoL) from the administered questionnaires will be compared at three years between the experimental and the standard of care arms. Subsequently, these outcomes will be modelled over a patient lifetime time horizon using trial data.

Source: https://euclinicaltrials.eu/ctis-public/view/2023-507307-64-00